EU clinical trial 2024-516221-31-00: Vaccination with autologous dendritic cells loaded with autologous tumour homogenate after curative resection for stage IV colorectal cancer: a phase II study (COREVAX-1)
Sponsor: Istituto Romagnolo Per Lo Studio Dei Tumori Dino Amadori IRST S.r.l. (Hospital/Clinic/Other health care facility). Phase: Therapeutic exploratory (Phase II). Countries: Italy (ongoing, recruiting).
Therapeutic area(s): Diseases [C] - Neoplasms [C04]
Gender: Female, Male. Age: 18-64 years, 65+ years. Enrolment: 19.
Status: Ongoing, recruiting. Start date (EU): 2016-04-19. Decision date: 2024-09-16. Results received: No. Last updated: 2024-09-16.

Condition(s): Stage IV colorectal cancer
Product: DC-VACCINE_IRSTIRCCS, Proleukin 18 x 106 UI Polvere per soluzione iniettabile o per infusione

Primary endpoint: Type, incidence, and severity of the adverse events, Quantification of the circulating immune effectors specific for a selected panel of tumour antigens, Immunohistochemistry on formalin-fixed, paraffin-embedded tumour samples will allow to evaluate the expression of tumour-associated antigen and to characterize the immune infiltrate.
Endpoint(s): RFS, OS, TTP, The potential predictive role of immunological response, as assessed by ELISPOT and DTH skin test, will also be assessed., Serum sampling will be performed before the first treatment cycle and at each disease restaging up to two years after treatment, to identify whether changes in markers values eventually found will predict disease relapse., Serum sampling will also allow the evaluation of a panel of proinflammatory cytokines during and after treatment

Source: https://euclinicaltrials.eu/ctis-public/view/2024-516221-31-00